EU clinical trial 2022-501644-15-01: A Randomized, Double-Blind, Placebo-Controlled, Parallel-Group Study to Assess the Efficacy, Safety, and Tolerability of BIIB080 in Subjects with Mild Cognitive Impairment Due to Alzheimer’s Disease or Mild Alzheimer’s Disease Dementia
Protocol code: 247AD201
Sponsor: Biogen Idec Research Limited (Pharmaceutical company). Phase: Therapeutic exploratory (Phase II). Countries: Finland (ongoing, recruitment ended), Spain (ongoing, recruitment ended), Germany (ongoing, recruitment ended), Sweden (ongoing, recruitment ended), France (ongoing, recruitment ended), Denmark (ongoing, recruitment ended), Belgium (ongoing, recruitment ended), Poland (ongoing, recruitment ended), Netherlands (ongoing, recruitment ended), Italy (ongoing, recruitment ended), Czechia (ongoing, recruitment ended).
Therapeutic area(s): Diseases [C] - Nervous System Diseases [C10]
Gender: Female, Male. Age: 18-64 years, 65+ years. Enrolment: 233.
Status: Ongoing, recruitment ended. Start date (EU): 2023-09-28. Decision date: 2023-08-14. Results received: No. Last updated: 2026-02-24.
Decision dates by country: BE: 2023-08-17, DK: 2023-08-15, ES: 2023-08-16, FI: 2023-08-16, SE: 2023-08-17, FR: 2023-08-21, DE: 2023-08-16, PL: 2023-08-21, CZ: 2023-08-17, NL: 2023-08-14, IT: 2023-08-18

Condition(s): Mild Cognitive Impairment due to Alzheimer's Disease Alzheimer's Disease Dementia
Product: VIZAMYL 400 MBq/mL solution for injection, Neuraceq 300 MBq/mL solution for injection, BIIB080, BIIB080, Placebo for BIIB080: artificial cerebrospinal fluid diluent, solution for injection., VIZAMYL 400 MBq/mL solution for injection

Primary endpoint: Dose-response in change from Baseline to Week 76 on the CDR-SB
Endpoint(s): Change from Baseline to Week 76 on the CDR-SB, Change from Baseline to Week 76 on the following: • ADCS-ADL-MCI • ADAS-Cog 13 • MMSE • Modified iADRS • ADCOMS, Number of Participants With Treatment-Emergent Adverse Events (TEAEs) and Serious Adverse Events (SAEs)

Source: https://euclinicaltrials.eu/ctis-public/view/2022-501644-15-01